EU clinical trial 2024-515788-73-00: FFCD - 1703 - POCHI : PEMBROLIZUMAB in combination with XELOX or FOLFOX-BEVACIZUMAB in patients with Microsatellite Stable (MSS) metastatic colorectal cancer and a high immune infiltrate: a proof-of-concept study. Phase II – non-randomised- multicentre.
Protocol code: FFCD1703
Sponsor: Fondation Franc.Cancerologie Digestive (Hospital/Clinic/Other health care facility). Phase: Therapeutic exploratory (Phase II). Countries: France (ongoing, recruitment ended).
Therapeutic area(s): Diseases [C] - Neoplasms [C04]
Gender: Female, Male. Age: 18-64 years, 65+ years. Enrolment: 55.
Status: Ongoing, recruitment ended. Start date (EU): 2024-07-30. Decision date: 2024-07-30. Results received: No. Last updated: 2025-10-28.

Condition(s): MICROSATELLITE STABLE (MSS) METASTATIC COLORECTAL CANCER AND A HIGH IMMUNE INFILTRATE
Product: KEYTRUDA 25 mg/mL concentrate for solution for infusion, Avastin 25 mg/ml concentrate for solution for infusion., FLUOROURACIL, CAPECITABINE BIOGARAN 500 mg, comprimé pelliculé, Avastin 25 mg/ml concentrate for solution for infusion., OXALIPLATINE HOSPIRA 5 mg/ml, solution à diluer pour perfusion

Primary endpoint: The primary endpoint is the percentage of patients alive and without progression at 10 months. Progression is defined by: - radiological progression evaluated by the investigator according to RECIST v1.1 criteria. - death, whatever the cause
Endpoint(s): Overall survival: is defined as time between date of inclusion and date of death of patient (whatever the cause) or date of last news if patient is XML File Identifier: IjpoCuOJiXEw1TRpi8rHlb0n7yE= Page 28/63 alive, Grades 3 – 4 adverse events: will be evaluated according to NCI-CTC v4.0 criteria and described by maximum grade based on total duration of treatment and 30 days after treatment, Secondary resection rate (R0 and R1): is defined as the percentage of patients who underwent surgery on their metastatic lesions after the protocol treatment., Histological response in case of secondary resection: is evaluated according to the TRG (Rubbia-Brandt L et al. Annals Oncol 2007), in patients who underwent a secondary resection. This response is evaluated according to the various categories: TRG1/TRG 2/TRG 3/TRG 4/TRG 5., Outcome of tumour markers (CEA and CA19.9): the evolution of the markers will be analyzed by a graphic representation of the percentage change from baseline rate., Progression-free survival, according to the investigator (RECIST criteria): defined as time between date of inclusion and date of a first radiological progression or date of death (whatever the cause). Patients alive without progression will be censured at date of last news. According to iRECIST criteria, progression will be considered as an event if it is confirmed. If the patient dies before confirmation, the event will be considered as unconfirmed progression., The percentage of patients alive and without progression at 10 months (according to centralised review, RECIST and iRECIST criteria): progression is defined as radiological progression or death, whatever the cause. According to iRECIST criteria, the patient will be considered as in progression if progression is confirmed in the next 2 months., Time to progression, according to the investigator (RECIST criteria) and in centralised review (RECIST and iRECIST criteria): is defined as the time between date of inclusion and date of first progression (RECIST v1.1 criteria) or date of suspected progression if confirmed (iRECIST criteria)., Time to an objective response (according to the investigator and in centralised review, RECIST criteria): is defined as the time between the date of inclusion and the date of a first objective response (complete response or partial response) during treatment. Patients with no imaging study (or if best response is not evaluable, or patients not treated) will not be taken into account in the analysis., Best response during treatment (according to the investigator and in centralised review, RECIST criteria): the best response is described by a percentage according to different categories: complete response (CR), partial response (PR), stability (S), progression (P) and not evaluable (NE). The best objective response is evaluated during treatment based on different imaging studies and according to RECIST v1.1 criteria., Depth of response (according to the investigator and in centralised review, RECIST criteria): is defined as the relative difference between the sum total of the largest diameters of target lesions in NADIR (RECIST v1.1: in the absence of new lesions or progression of non-target lesions) and the sum total of the largest diameters of target lesions at inclusion., Early tumour shrinkage at 9 weeks, according to the investigator (RECIST criteria) and in centralised review (RECIST and iRECIST criteria): is defined as the relative difference between the sum of the largest diameters of the target lesions at 9 weeks and the sum of different targets at inclusion. Tumour shrinkage corresponds to a relative difference > 20% with RECIST v1.1 criteria and > 30% with iRECIST.

Source: https://euclinicaltrials.eu/ctis-public/view/2024-515788-73-00